EU clinical trial 2024-513885-20-00: Multi-center, double-blind, randomized, placebo-controlled, parallel-group, polysomnography, dosefinding study assessing the efficacy, safety, and pharmacokinetics of multiple-dose oral administration of daridorexant in pediatric subjects aged 10 to < 18 years with insomnia disorder
Protocol code: ID-078A205
Sponsor: Idorsia Pharmaceuticals Ltd. (Pharmaceutical company). Phase: Therapeutic exploratory (Phase II). Countries: Germany (ended), Bulgaria (ended), Spain (ended), Italy (ended).
Therapeutic area(s): Diseases [C] - Nervous System Diseases [C10]
Gender: Female, Male. Age: 0-17 years. Enrolment: 69.
Status: Ended. Start date (EU): 2022-12-05. End date (EU): 2026-02-03. End date: 2026-02-05. Decision date: 2024-10-31. Results received: Yes. Last updated: 2026-02-23.
Decision dates by country: ES: 2024-10-31, IT: 2024-11-05, DE: 2024-11-18, BG: 2024-11-04

Condition(s): Insomnia Disorder
Product: Daridorexant matching placebo, QUVIVIQ 50 mg film-coated tablets, QUVIVIQ 25 mg film-coated tablets

Primary endpoint: Change from baseline to Day 1 in TST (in min) as measured by polysomnography (PSG). PSG will be performed on 2 nights during the screening period and on Day 1 of the treatment period (total time frame: 3 days). Baseline is defined as the mean of the 2 PSG nights during the screening period.

Source: https://euclinicaltrials.eu/ctis-public/view/2024-513885-20-00